EU clinical trial 2023-509495-42-00: CONGRATS : COMBINATION OF NIVOLUMAB PLUS RELATLIMAB IN PATIENTS WITH ADVANCED OR METASTATIC SOFT-TISSUE SARCOMA: A PROOF-OF-CONCEPT RANDOMIZED PHASE II STUDY
Protocol code: IB 2019-03
Sponsor: Institut Bergonie (Hospital/Clinic/Other health care facility). Phase: Therapeutic exploratory (Phase II). Countries: France (ended).
Therapeutic area(s): Diseases [C] - Neoplasms [C04]
Gender: Female, Male. Age: 18-64 years, 65+ years. Enrolment: 67.
Status: Ended. Start date (EU): 2020-02-27. End date (EU): 2026-03-29. Decision date: 2024-09-25. Results received: No. Last updated: 2026-02-25.

Condition(s): Adult participants with advanced unresectable or metastatic soft-tissue sarcoma.
Product: OPDIVO 10 mg/mL concentrate for solution for infusion., Relatlimab intravenous

Primary endpoint: Efficacy of nivolumab in association with relatlimab (Arm A) as well of efficacy of nivolumab alone (Arm B) will be assessed, independently for each arm, in terms of 6-month progression-free rate (6-month PFR). This endpoint is a validated endpoint in STS (Van Glabbeke, EJC 2002):, 1a) PFR is defined as the rate of complete or partial response (CR, PR) or stable disease (SD), as per RECIST 1.1. The PFR at 6 months will be reported. Note that confirmation of claimed responses at 4 weeks later is not required., 1b) Disease status at 6 months will be centrally reviewed for all patients by an expert radiologist blinded to the treatment. Centralized radiological reviewed data will be used for the primary efficacy analysis., 1c) No statistical comparison of efficacy between arms will be performed.
Endpoint(s): Anti-tumor activity will be assessed, independently for each arm, in terms of additional efficacy endpoints:, 1a) Best overall response is defined as the best response across all time points (RECIST 1.1). The best overall response is determined once all the data for the patient is known (RECIST 1.1). Note that confirmation of claimed responses at 4 weeks later is not required., 1b) Progression-free survival (PFS) is defined as the delay between the start date of treatment and the date of progression (as per RECIST 1.1) or death (from any cause), whichever occurs first. Median PFS, 1- and 2-year PFS rates will be reported independently for each arm., 1c) Overall survival (OS) defined as the delay between the start date of treatment and the date of death (of any cause). Median OS, 1- and 2-year OS rate will be reported independently for each arm., 1d) GMI is defined for each patient as ratio of its PFS on the nivolumab+BMS-986016 treatment combination to its PFS on the previous line of therapy, in patients with documented progression at inclusion. This accounts for inter-patient variability, the patient serving as his/her own control and implies by the natural history of the disease that the PFS tends to become shorter in successive lines of therapy. It is thought that an anti-cancer agent should be considered effective if the GMI is >1.3, The safety profile of the association. Events will be graded using the Common Terminology Criteria for Adverse Events (CTCAE) from the NCI v5.0. Both AE and SAE will be coded according to the standardized medical terminology MedDRA., Ancillary pharmacodynamic study:, 7a) Blood : samples will be collected at predefined time points for assessment of serum cytokines levels, as well as levels of Kynurenine and Kynurenine to Tryptophan ratio (ELISA and LC/MS) and lymphocytes subpopulations monitoring (flow cytometry), 7b) Tumor: Mandatory Fresh pre-treatment and on-treatment tumor biopsies (FFPE + FF) will be collected to perform Hematoxylin and eosin staining (H&E) and IHC assessments including, but not limited to the following markers: IDO1, CSF-1R, PDL1, LAG3, CD68, CD163, CD8, Ki67 and other exploratory markers. The analysis will be prioritized based on the amount of material available., 7c) Stool samples will be collected at baseline to evaluate the potential role of the gut microbiome in modulating the immune response (16S rRNA)., Exploratory analysis: 6-month PFS rates will be evaluated and compared across the two arms.

Source: https://euclinicaltrials.eu/ctis-public/view/2023-509495-42-00